EU clinical trial 2024-516256-18-00: A study in healthy people to test whether BI 1291583 influences the amount of dabigatran in the body
Protocol code: 1397-0022
Sponsor: Boehringer Ingelheim International GmbH (Pharmaceutical company). Phase: Human Pharmacology (Phase I)- Other. Countries: Germany (ended).
Therapeutic area(s): Not possible to specify
Gender: Male. Age: 18-64 years. Enrolment: 14.
Status: Ended. Start date (EU): 2025-01-20. End date (EU): 2025-03-27. Decision date: 2024-11-07. Results received: No. Last updated: 2025-03-12.

Condition(s): Healthy volunteer trial

Source: https://euclinicaltrials.eu/ctis-public/view/2024-516256-18-00